EU clinical trial 2023-505283-11-00: A phase IV, prospective, multicenter, open-label, mother-milk study to evaluate ofatumumab concentration in the breast milk of lactating women with relapsing forms of multiple sclerosis receiving ofatumumab (Kesimpta®)
Protocol code: COMB157G2410
Sponsor: Novartis Pharma AG (Pharmaceutical company). Phase: Therapeutic use (Phase IV). Countries: Germany (ongoing, recruitment ended), France (not authorised), Italy (ended), Poland (ongoing, recruitment ended).
Therapeutic area(s): Diseases [C] - Nervous System Diseases [C10]
Gender: Female. Age: 18-64 years. Enrolment: 15.
Start date (EU): 2024-12-10. Decision date: 2024-06-06. Results received: No. Last updated: 2025-07-07.
Decision dates by country: FR: 2024-06-06, IT: 2025-05-19, PL: 2025-06-08, DE: 2024-06-06

Condition(s): Relapsing forms of Multiple Sclerosis (RMS)
Product: Kesimpta 20 mg solution for injection in pre-filled syringe

Primary endpoint: The concentration of ofatumumab in breast milk at the following timepoints: (pre-dose) on the day of the second (or any subsequent) maintenance dose, then 7, 14, 21 and (pre-dose) 28 days after the second (or any subsequent) maintenance dose.
Endpoint(s): Proportion of participants with at least 1 sample with quantifiable ofatumumab concentrations in breast milk, Maximum concentration (Cmax) of ofatumumab in breast milk over 28 days after the second (or any subsequent) maintenance dose., The exposure (area under the curve (AUC) of ofatumumab in milk over 28 days (from the second or any subsequent maintenance dose to the next maintenance dose after initiation or re-initiation of ofatumumab post-partum), Milk/Plasma (M/P) ratio of ofatumumab at 28 days after the second or any subsequent maintenance dose., Estimated relative infant dose (RID, %) over 28 days after the lactating mother receives second or subsequent maintenance dose, Rate and nature of adverse events in the mothers treated with ofatumumab up to 12 months after ofatumumab treatment initiation/re-initiation, Rate and nature of serious adverse events and any infections in the breast-fed infants of mothers up to 12 months after ofatumumab treatment initiation/re-initiation

Source: https://euclinicaltrials.eu/ctis-public/view/2023-505283-11-00